EU clinical trial 2024-513982-38-00: RAR-Immune: A randomised, comparative, prospective, multicentre study of the efficacy of nivolumab + ipilimumab versus pazopanib alone in patients with metastatic or unresectable advanced sarcoma of rare subtype
Sponsor: Centre Leon Berard (Hospital/Clinic/Other health care facility). Phase: Therapeutic confirmatory (Phase III). Countries: France (ended).
Therapeutic area(s): Diseases [C] - Neoplasms [C04]
Gender: Female, Male. Age: 18-64 years, 65+ years. Enrolment: 112.
Status: Ended. Start date (EU): 2021-03-17. End date (EU): 2025-11-24. Decision date: 2024-10-18. Results received: No. Last updated: 2026-02-02.

Condition(s): Metastatic or unresectable advanced rare sarcomas
Product: IPILIMUMAB, NIVOLUMAB, PAZOPANIB

Primary endpoint: The primary endpoint will be Progression-Free Survival, defined as the time from the date of randomisation to the date of first documented progression or death due to any cause. Patients who have not progressed or died at the time of analysis will be censored at the time of the latest date of assessment
Endpoint(s): The Best Overall Response will be defined as the best among all overall responses during the trial, The Objective Response Rate will be defined as the proportion of patients with a best overall response of CR or PR during the trial., The duration of response will be applied only to patients whose BOR is either CR or PR and will be defined as the time from the date of first documented tumour response to the date of first documented disease progression or death due to underlying cancer. Patients with no event at the time of the analysis will be censored at the date of last adequate tumour assessment., The Time to Treatment Failure will be defined as the time from the date of randomisation to the date of permanent study treatments discontinuation (any cause, including disease progression, treatment toxicity, adverse event, start of any new anticancer therapy, withdrawal of consent and death). Patients without treatment failure at the time of the analysis will be censored at the date of last tumour assessment., The Overall Survival will be defined as the time from the date of randomisation to the date of death due to any cause. Any patient not known to have died at the time of analysis will be censored based on the last recorded date on which the patient was known to be alive., The Quality of Life will be assessed using the EORTC QLQ-C30 questionnaire., The tolerance profile will be described through the incidence and severity of drug-related AEs according to the Common Terminology Criteria for Adverse Events (CTCAE) (v5.0), The Progression-Free Survival i-RECIST (in the experimental arm) will be defined as the time from the date of randomisation to the date of first documented progression or death due to any cause., Translational research: Translational research will be conducted by a team from the “Centre de Recherche en Cancérologie of Lyon” (Centre Léon Bérard, Lyon). The objectives are to identify: - biomarkers predicting the therapeutic response for immunotherapy in rare sarcomas - resistance pathways and new targets for immunotherapy in rare sarcomas, Exploratory objectives: According to the guidelines from the RECIST working group, efforts should be made to introduce the immune-related Response Criteria in clinical trials in which immunotherapy is used18. In experimental arm, overall response will also be assessed using iRECIST: iPFS, iBOR and iORR. Any documented disease progression (RECIST) will be confirmed 4-6 weeks later.

Source: https://euclinicaltrials.eu/ctis-public/view/2024-513982-38-00